EU clinical trial 2024-519550-36-00: International multicentre, open-label, phase IV clinical trial to evaluate the efficacy, safety and effect on quality of life of bilastine in children with allergic rhinoconjunctivitis
Protocol code: BILA-4124/PED
Sponsor: Faes Farma S.A., A. Menarini Industrie Farmaceutiche Riunite S.r.l. (Pharmaceutical company). Phase: Therapeutic use (Phase IV). Countries: Poland (ongoing, recruiting), Spain (ongoing, recruiting), Italy (ongoing, recruiting).
Therapeutic area(s): Diseases [C] - Immune System Diseases [C20]
Gender: Female, Male. Age: 0-17 years. Enrolment: 70.
Status: Ongoing, recruiting. Start date (EU): 2026-03-30. Decision date: 2026-01-19. Results received: No. Last updated: 2026-01-26.
Decision dates by country: IT: 2026-01-19, ES: 2026-01-19, PL: 2026-01-26

Condition(s): Allergic rhinoconjunctivitis
Product: Bilaxten Flas 10 mg comprimidos bucodispersables

Primary endpoint: Overall AR symptoms will be evaluated through the mean change of the T5CSS score measured at baseline (V1) and after 14 days (V3) of treatment by a participant’s e-diary

Source: https://euclinicaltrials.eu/ctis-public/view/2024-519550-36-00